EU clinical trial 2024-519151-28-00: A Study of LY4057996 in Healthy Participants and Participants with Type 1 and Type 2 Diabetes (YKAA)
Protocol code: J6B-MC-YKAA
Sponsor: Eli Lilly & Co. (Pharmaceutical company). Phase: Human Pharmacology (Phase I)- First administration to humans. Countries: Germany (ongoing, recruiting).
Therapeutic area(s): Diseases [C] - Nutritional and Metabolic Diseases [C18]
Gender: Female, Male. Age: 18-64 years. Enrolment: 132.
Status: Ongoing, recruiting. Start date (EU): 2025-05-14. Decision date: 2025-04-24. Results received: No. Last updated: 2026-03-20.

Condition(s): Healthy, Diabetes Mellitus, Type 1; Diabetes Mellitus, Type 2

Source: https://euclinicaltrials.eu/ctis-public/view/2024-519151-28-00